EU clinical trial 2022-503117-36-00: A Phase II, Multicenter, Randomized, Placebo-Controlled, Double-Blind Study to Evaluate the Pharmacodynamics, Safety, Tolerability, Pharmacokinetics, and Efficacy of RO7204239 in Participants With Facioscapulohumeral Muscular Dystrophy
Protocol code: BN43703
Sponsor: F. Hoffmann-La Roche AG (Pharmaceutical company). Phase: Therapeutic exploratory (Phase II). Countries: Italy (ongoing, recruitment ended), Denmark (ongoing, recruitment ended).
Therapeutic area(s): Diseases [C] - Musculoskeletal Diseases [C05]
Gender: Female, Male. Age: 18-64 years. Enrolment: 27.
Status: Ongoing, recruitment ended. Start date (EU): 2022-12-01. Decision date: 2024-02-19. Results received: No. Last updated: 2026-03-17.
Decision dates by country: IT: 2024-02-23, DK: 2024-04-19

Condition(s): Facioscapulohumeral muscular dystrophy (FSHD)
Product: RO7204239, GYM329 Placebo

Primary endpoint: 1. Percent change from baseline in contractile muscle volume (CMV) of quadriceps femoris muscles, as assessed by MRI bilaterally, 2. Incidence, severity, and causal relationship of adverse events, with severity determined according to National Cancer Institute Common Terminology Criteria for Adverse Events v5.0, 3. Change from baseline in vital signs, physical findings, ECG, echocardiogram, and clinical laboratory results, 4. Incidence of local and systemic injection reactions, 5. Incidence of abnormal laboratory findings, 6. Incidence of abnormal ECG parameters, 7. Incidence of abnormal echocardiographic parameters, 8. Incidence of abnormal vital signs
Endpoint(s): 1. Change from baseline in serum concentrations of total and free latent myostatin, and mature myostatin, 2. Percent change from baseline in CMV of 36 muscles based on whole body MRI (excluding muscles with severe fat replacement), 3. Change from baseline in fat fraction of 36 muscles based on whole body MRI (excluding muscles with severe fat replacement), 4. Percent change from baseline in CMV of quadriceps femoris muscles, as assessed by MRI bilaterally, 5. Change from baseline in fat fraction of quadriceps femoris muscles, as assessed by MRI bilaterally, 6. Percent change from baseline in CMV of tibialis anterior muscles, as assessed by MRI bilaterally, 7. Change from baseline in fat fraction of tibialis anterior muscles, as assessed by MRI bilaterally, 8. Percent change from baseline in CMV of biceps brachii muscles, as assessed by MRI bilaterally, 9. Change from baseline in fat fraction of biceps brachii muscles, as assessed by MRI bilaterally, 10. Percent change from baseline in the contractile cross-sectional area (CSA) of skeletal muscle in the proximal lower limb muscles, as assessed by MRI bilaterally, 11. Change from baseline in the fat fraction of proximal lower limb muscles, as assessed at a single mid femur slice by MRI bilaterally, 12. Serum concentrations of RO7204239 at specified timepoints, 13. Cmax of RO7204239 at specified timepoints, 14. Area under the concentration-time curve (AUC) of RO7204239 at specified timepoints, 15. Ctrough of RO7204239 at specified timepoints, 16. Prevalence of anti-drug antibodies (ADAs) at baseline and incidence of ADAs during the study

Source: https://euclinicaltrials.eu/ctis-public/view/2022-503117-36-00